EU clinical trial 2023-505918-14-00: Prospective, randomised, double-blind, placebo-controlled multicenter clinical trial to evaluate efficacy and safety of sublingual immunotherapy in patients with rhinitis/rhinoconjunctivitis with or without mild to moderate asthma, allergic to Dermatophagoides pteronyssinus and/or Dermatophagoides farinae_MM09-SLG-058
Protocol code: MM09-SLG-058
Sponsor: Inmunotek S.L. (Pharmaceutical company). Phase: Therapeutic confirmatory (Phase III). Countries: Spain (ongoing, recruiting), Portugal (authorised, recruiting).
Therapeutic area(s): Diseases [C] - Immune System Diseases [C20]
Gender: Female, Male. Age: 0-17 years, 18-64 years, 65+ years. Enrolment: 147.
Start date (EU): 2025-07-16. Decision date: 2024-07-26. Results received: No. Last updated: 2026-07-29.
Decision dates by country: ES: 2024-07-26, PT: 2024-07-30

Condition(s): Aetiological treatment of moderate to severe rhinitis/rhinoconjunctivitis with or without mild to moderate controlled allergic asthma
Product: Sublingual MM09, The IMP placebo is a solution identical in composition to the active treatment, but without active ingredients.

Primary endpoint: The mean of the daily Rhinitis/Rhinoconjunctivitis Combined Symptom and Medication Score (RCSMS) during the Main Evaluation Period (the last 4 week of IMP treatment) by means of the Participant’s Diary
Endpoint(s): Rhinitis/Rhinoconjunctivitis Symptom Score (RSS), Rhinitis/Rhinoconjunctivitis Medication Score (RMS)., Asthma and Rhinitis/Rhinoconjunctivitis Combined Symptom and Medication Score (ACSMS)., Asthma Symptom Score (ASS), Asthma Medication Score (AMS), Asthma and Rhinitis/Rhinoconjunctivitis Symptom Score (ARSS), Asthma and Rhinitis/Rhinoconjunctivitis Medication Score (ARMS), Asthma and Rhinitis/Rhinoconjunctivitis Combined Symptom and Medication Score (ARCSMS), Asthma exacerbations: Time to first exacerbation; number, duration, and severity of exacerbations, Immunological parameters in blood samples: - Total IgE - Specific IgE for D. pteronyssinus and D. farinae - Specific IgE for D. pteronyssinus and D. farinae /Total IgE ratio, Allergen profiling (ALEX technique), if serum is available, Rhinoconjunctivitis Quality of Life Questionnaire (RQLQ), Participant and investigator health status perception through a Visual Analogue Scale (VAS), Consumption of health resources., Safety parameters: - Overall rate and severity of adverse events (AE) per administration and per participant. - Evaluation of reactions at the site of administration, systemic reactions and of any medication administered for the treatment of the AE

Source: https://euclinicaltrials.eu/ctis-public/view/2023-505918-14-00